EU clinical trial 2023-504256-10-00: Effects of promethazine and altered gravity on bimanual coordination
Protocol code: BMC in AG
Sponsor: Novespace (Pharmaceutical company). Phase: Therapeutic use (Phase IV). Countries: France (ended).
Therapeutic area(s): Phenomena and Processes [G] - Physiological processes [G07]
Gender: Female, Male. Age: 18-64 years. Enrolment: 16.
Status: Ended. Start date (EU): 2023-06-10. End date (EU): 2023-06-15. Decision date: 2023-06-02. Results received: Yes. Last updated: 2023-06-02.

Condition(s): Healthy volunteers
Product: Comprimé placebo à usage thérapeutique commercialisé par centrelab sous la référence f00199. Composition : - hydrogénophosphate de calcium dihydraté : 244,4 mg - amidon de maïs : 13 mg - stéarate de magnésium : 2,6 mg, PHENERGAN 25 mg, comprimé enrobe.

Primary endpoint: Bimanual coordination performance, assessed by the harmonicity

Source: https://euclinicaltrials.eu/ctis-public/view/2023-504256-10-00